EU clinical trial 2023-507300-30-00: Effect of Erythromycin on the absorption, metabolism and elimination of CHF6001 in healthy volunteers
Protocol code: CLI-06001AA1-14
Sponsor: Chiesi Farmaceutici S.p.A. (Pharmaceutical company). Phase: Human Pharmacology (Phase I)- Other. Countries: Bulgaria (ended).
Therapeutic area(s): Diseases [C] - Respiratory Tract Diseases [C08]
Gender: Female, Male. Age: 18-64 years. Enrolment: 24.
Status: Ended. Start date (EU): 2024-03-27. End date (EU): 2024-06-18. Decision date: 2024-02-12. Results received: No. Last updated: 2024-02-12.

Condition(s): This study is a phase I trial to investigate the effect of inhibition of CYP3A4/5 by Erythromycin on the pharmacokinetics of CHF6001 in healthy volunteers.

Source: https://euclinicaltrials.eu/ctis-public/view/2023-507300-30-00